EU clinical trial 2025-521317-50-00: Efficacy of Ursodeoxycholic Acid versus Corticosteroids for the Treatment of Cholestatic Hepatitis Secondary to Immunotherapy: A Multicenter, Controlled, Randomized, Open Trial
Sponsor: Centre Hospitalier Universitaire De Montpellier (Hospital/Clinic/Other health care facility). Phase: Therapeutic confirmatory (Phase III). Countries: France (ongoing, recruiting).
Therapeutic area(s): Diseases [C] - Digestive System Diseases [C06]; Diseases [C] - Neoplasms [C04]
Gender: Female, Male. Age: 18-64 years, 65+ years. Enrolment: 94.
Status: Ongoing, recruiting. Start date (EU): 2026-06-25. Decision date: 2025-10-30. Results received: No. Last updated: 2025-11-17.
Decision dates by country: FR: 2025-11-17

Condition(s): Cholestatic hepatitis induced by immune checkpoint inhibitors (ICIs)
Product: CORTANCYL 20 mg, comprimé sécable, URSODEOXYCHOLIC ACID

Primary endpoint: The rate of patients showing an improvement of at least 25% in liver function tests (alkaline phosphatase and/or gamma-GT) from baseline on Day 21.
Endpoint(s): Rate of patients with resolution of hepatitis, i.e., grade ≤ 1 according to the current NCI CTC-AE classification, at 6 months after randomization, the time to hepatitis resolution (grade ≤ 1) defined as the time from the date of randomization to the date of resolution of hepatitis, the tolerance to UDCA or corticosteroids or both: Adverse events assessed according to the current NCI-CTC AE classification, Factors associated with response to UDCA at D21 among the immunotherapy molecule, duration of ICI treatment, presence or absence of bile duct dilation, tumor histology, Rate of patients in whom resumption of immunotherapy was possible after hepatitis within 12 months after randomization

Source: https://euclinicaltrials.eu/ctis-public/view/2025-521317-50-00